EU clinical trial 2025-523301-15-00: A first-in-human study to learn about how safe BAY 3620122 is, how much of it gets absorbed in the blood, and how it affects the body of healthy participants
Protocol code: 22967
Sponsor: Bayer AG (Pharmaceutical company). Phase: Human Pharmacology (Phase I)- First administration to humans. Countries: Germany (ended).
Therapeutic area(s): Diseases [C] - Cardiovascular Diseases [C14]
Gender: Female, Male. Age: 18-64 years. Enrolment: 190.
Status: Ended. Start date (EU): 2025-12-17. End date (EU): 2026-08-05. Decision date: 2025-11-11. Results received: No. Last updated: 2026-03-05.

Condition(s): Vasodilatory shock

Source: https://euclinicaltrials.eu/ctis-public/view/2025-523301-15-00